EU clinical trial 2023-504988-16-00: The effect of semaglutide therapy on hepatic fat content and on the acute reponse of liver fat to high-fat load in obese MASLD patients
Protocol code: IKEM-ISS-02
Sponsor: Institut Klinicke A Experimentalni Mediciny (Hospital/Clinic/Other health care facility). Phase: Therapeutic confirmatory (Phase III). Countries: Czechia (authorised, recruitment pending).
Therapeutic area(s): Diseases [C] - Nutritional and Metabolic Diseases [C18]
Gender: Male. Age: 18-64 years, 65+ years. Enrolment: 16.
Status: Authorised, recruitment pending. Decision date: 2023-06-02. Results received: No. Last updated: 2025-05-28.

Condition(s): Obesity
Product: SEMAGLUTIDE

Primary endpoint: hepatic fat content assessed by magnetic resonance spectroscopy (MRS) and hepatic fat volume (= liver volume * hepatic fat content) determined after 14 and 16 weeks of intervention (average value from 2 examinations performed before high-fat load), acute response of hepatic fat content (assessed by MRS) to high-fat load (cream, 150 g of fat) and to a high-fat load co-administered with glucose (3 x 50 g in 2-hour intervals) – hepatic fat content will be measured before and 6 hours after high-fat load (ΔHFC = HFC6 = HFC0, where HFC0 is the hepatic fat content before fat load and HFC6 the hepatic fat content 6 hours after fat load expressed in volume %)
Endpoint(s): body weight, waist circumference, body composition (Inbody), the quantity of subcutaneous and visceral fat assessed by MR, and BMI assessed after 14 and 16 weeks of intervention, insulin resistence assessed as HOMA-IR after 14 and 16 weeks of intervention, the change of concentration of adipokines and other metabolic factors that could expleain the effects of semaglutide on liver fat (adiponectin, leptin, etc.)

Source: https://euclinicaltrials.eu/ctis-public/view/2023-504988-16-00